EU clinical trial 2024-511142-39-00: A Phase III, Randomised, Double Blind, Placebo Controlled, Multicentre Study of Olaparib Maintenance Monotherapy in Patients With BRCA Mutated Advanced (FIGO Stage III-IV) Ovarian Cancer Following First Line Platinum Based Chemotherapy.
Protocol code: SOLO 1-D0818C00001
Sponsor: AstraZeneca AB (Pharmaceutical company). Phase: Therapeutic confirmatory (Phase III). Countries: Poland (ongoing, recruitment ended), Spain (ongoing, recruitment ended), Netherlands (ongoing, recruitment ended), France (ongoing, recruitment ended), Italy (ongoing, recruitment ended).
Therapeutic area(s): Diseases [C] - Neoplasms [C04]
Gender: Female. Age: 18-64 years, 65+ years. Enrolment: 88.
Status: Ongoing, recruitment ended. Start date (EU): 2013-09-06. Decision date: 2024-03-15. Results received: No. Last updated: 2026-07-02.
Decision dates by country: NL: 2024-03-20, IT: 2024-04-22, PL: 2024-03-20, ES: 2024-03-18, FR: 2024-03-15

Condition(s): BRCA Mutated Advanced (FIGO Stage III-IV) Ovarian Cancer
Product: Lynparza 100 mg film-coated tablets, Placebo - film-coated tablets, Lynparza 150 mg film-coated tablets

Primary endpoint: Progression Free Survival (PFS) by investigator review of RECIST data
Endpoint(s): Efficacy in patients following First Line Platinum Based Chemotherapy by assessment of: a) overall survival b) time to earliest progression by RECIST or Cancer Antigen-125 (CA- 125) c) time from randomisation to second progression., The Trial Outcome Index (TOI) of the Functional Assessment of Cancer Therapy - Ovarian Cancer (FACT-O) will be used to determine: a) Change from baseline in TOI score b) Proportion improved, Development and delivery of a BRCA mutation companion diagnostic, Adverse events, physical examination, vital signs including blood pressure, pulse, electrocardiogram and laboratory findings including clinical chemistry and haematology, Efficacy of olaparib by time to first subsequent therapy or death (TFST)., Efficacy of olaparib by time to second subsequent therapy or death (TSST)., Efficacy of olaparib by time from randomisation to study treatment discontinuation or death (TDT).

Source: https://euclinicaltrials.eu/ctis-public/view/2024-511142-39-00